EU clinical trial 2024-513721-23-00: RESTORING SENSITIVITY TO IMMUNOTHERAPY IN ADVANCED TRIPLE NEGATIVE BREAST CANCER EXPLOITING CERALASERTIB PRIMING FOLLOWED BY COMBINED DURVALUMAB/NAB-PACLITAXEL: THE ATRiBRAVE TRIAL
Protocol code: IFOM-CPT008/2022/PO0
Sponsor: IFOM Istituto Fondazione Di Oncologia Molecolare Ets In Breve Ifom Ets (Laboratory/Research/Testing facility). Phase: Therapeutic exploratory (Phase II). Countries: Italy (ongoing, recruitment ended).
Therapeutic area(s): Diseases [C] - Neoplasms [C04]
Gender: Female, Male. Age: 18-64 years, 65+ years. Enrolment: 37.
Status: Ongoing, recruitment ended. Start date (EU): 2022-12-15. Decision date: 2024-08-12. Results received: No. Last updated: 2026-01-08.

Condition(s): ADVANCED TRIPLE NEGATIVE BREAST CANCER
Product: DURVALUMAB, PACLITAXEL ALBUMIN-BOUND, Ceralasertib

Primary endpoint: Progression free survival (PFS), defined as the number of days between the first study treatment administration to the date of first documented disease progression, relapse or death from any cause.
Endpoint(s): Overall Response Rate (ORR) according to RECIST v 1.1 criteria, Disease Control Rate (DCR) defined as the percentage of subjects whose disease shrinks or remains stable at 12 weeks. DCR is the sum of the complete response (CR), partial response (PR) and stable disease (SD) rates, Clinical Benefit Rate (CBR) defined as the proportion of patients with no disease progression at 24 weeks, Duration of Response (DoR) defined as the time from the date of first documented confirmed response until date of documented progression per RECIST v1.1 or death due to any cause, Overall Survival (OS) defined as the number of days between the first study treatment administration and death, Occurrence of Adverse Events (AEs), including treatment-related AEs and AEs of special interest

Source: https://euclinicaltrials.eu/ctis-public/view/2024-513721-23-00